EU clinical trial 2024-512373-27-00: GUIDANCE – A multicenter phase II trial of maintenance durvalumab and olaparib after standard 1st line treatment (carboplatin/ cisplatin, etoposide, durvalumab) in HRD positive extensive disease (ED) small-cell lung cancer (SCLC)
Protocol code: Uni-Koeln-5159
Sponsor: University Of Cologne (Educational Institution). Phase: Therapeutic exploratory (Phase II). Countries: Germany (ongoing, recruiting).
Therapeutic area(s): Diseases [C] - Neoplasms [C04]; Diseases [C] - Respiratory Tract Diseases [C08]
Gender: Female, Male. Age: 18-64 years, 65+ years. Enrolment: 29.
Status: Ongoing, recruiting. Start date (EU): 2024-09-30. Decision date: 2024-09-23. Results received: No. Last updated: 2026-07-21.

Condition(s): Advanced/inoperable or metastatic small-cell lung cancer
Product: IMFINZI 50 mg/mL concentrate for solution for infusion., Lynparza 100 mg film-coated tablets, Lynparza 150 mg film-coated tablets

Primary endpoint: Progression-free survival (PFS) according to investigator-assessed RECIST 1.1 from start of maintenance therapy
Endpoint(s): Incidence, severity and grading of AEs and SAEs, frequency of dose interruptions and reductions, Objective response rate (best response) of maintenance (ORR), duration of response (DOR) and disease control rate (DCR) according to investigatorassessed RECIST 1.1, immune objective response rate (iORR), immune duration of response (iDOR), immune disease control rate (iDCR), immune progression-free survival (iPFS) according to iRECIST and OS, PFS, ORR, DOR and DCR according to investigator-assessed RECIST 1.1, iORR, iDOR, iDCR, iPFS according to iRECIST and OS in pre-specified patient subgroups

Source: https://euclinicaltrials.eu/ctis-public/view/2024-512373-27-00